EU clinical trial 2025-520927-26-00: A Phase 3 Randomized, Double-blind, Placebo-controlled Study of JNJ-78278343, a T-cell-redirecting Agent Targeting Human Kallikrein 2 Versus Placebo for Metastatic Castration-resistant Prostate Cancer
Protocol code: 78278343PCR3001
Sponsor: Janssen Cilag International (Pharmaceutical company). Phase: Therapeutic confirmatory (Phase III). Countries: France (ongoing, recruiting), Belgium (ongoing, recruiting), Spain (ongoing, recruiting), Poland (ongoing, recruiting), Italy (ongoing, recruiting), Netherlands (ongoing, recruiting), Germany (ongoing, recruiting).
Therapeutic area(s): Diseases [C] - Neoplasms [C04]
Gender: Male. Age: 18-64 years, 65+ years. Enrolment: 215.
Status: Ongoing, recruiting. Start date (EU): 2025-11-24. Decision date: 2025-11-18. Results received: No. Last updated: 2026-07-10.
Decision dates by country: IT: 2025-11-20, FR: 2026-01-27, NL: 2025-11-24, DE: 2025-11-24, PL: 2025-11-21, BE: 2025-11-18, ES: 2025-11-20

Condition(s): Metastatic Castration-resistant Prostate Cancer (mCRPC)
Product: JNJ-78278343, JNJ-78278343, Placebo JNJ-78278343, Placebo JNJ-78278343

Primary endpoint: Overall survival

Source: https://euclinicaltrials.eu/ctis-public/view/2025-520927-26-00